EU clinical trial 2023-510273-34-00: A Phase 2, Two-arm Multicenter, Open-Label Study to Determine the Efficacy and the Safety of Two Different Dose Regimens of a pan-FGFR Tyrosine Kinase Inhibitor JNJ-42756493 in Subjects with Metastatic or Surgically Unresectable Urothelial Cancer with FGFR Genomic Alterations
Protocol code: 42756493BLC2001
Sponsor: Janssen Cilag International (Pharmaceutical company). Phase: Therapeutic exploratory (Phase II). Countries: Spain (ended), France (ongoing, recruitment ended).
Therapeutic area(s): Diseases [C] - Neoplasms [C04]
Gender: Female, Male. Age: 18-64 years, 65+ years. Enrolment: 5.
Start date (EU): 2015-04-24. Decision date: 2024-02-12. Results received: No. Last updated: 2026-06-09.
Decision dates by country: ES: 2024-02-12, FR: 2024-02-20

Condition(s): Urothelial cancer
Product: JNJ-42756493, JNJ-42756493, Midazolam-ratiopharm® 2 mg/ml orale Lösung, Metformin HEXAL 1000 mg Filmtabletten, JNJ-42756493

Primary endpoint: Percentage of Participants with Best Overall Response, The endpoints are PK parameters for midazolam and its metabolite (1-OH-midazolam), and for metformin (in the absence or presence of erdafitinib) including but not limited to Cmax, tmax, AUClast, and AUC∞.

Source: https://euclinicaltrials.eu/ctis-public/view/2023-510273-34-00